EU clinical trial 2025-521329-34-00: A study understanding how much CDR132L enters the bloodstream after injection under the skin compared to injection into a vein in healthy participants
Protocol code: NN6706-8230
Sponsor: Novo Nordisk A/S (Pharmaceutical company). Phase: Human Pharmacology (Phase I)- Bioequivalence Study. Countries: Germany (ongoing, recruiting).
Therapeutic area(s): Diseases [C] - Cardiovascular Diseases [C14]
Gender: Female, Male. Age: 18-64 years. Enrolment: 32.
Status: Ongoing, recruiting. Start date (EU): 2026-06-10. Decision date: 2026-01-26. Results received: No. Last updated: 2026-07-31.

Condition(s): Healthy volunteers, treatment for heart failure

Source: https://euclinicaltrials.eu/ctis-public/view/2025-521329-34-00